EU clinical trial 2025-521402-18-00: Phase 1 Study to Determine the Effect of CYP Induction Following Administration of Nirogacestat in Healthy Men Participants
Protocol code: NIR-DT-106
Sponsor: Springworks Therapeutics Inc. (Pharmaceutical company). Phase: Human Pharmacology (Phase I)- Other. Countries: Netherlands (ended).
Therapeutic area(s): Diseases [C] - Skin and Connective Tissue Diseases [C17]
Gender: Male. Age: 18-64 years. Enrolment: 16.
Status: Ended. Start date (EU): 2025-10-24. End date (EU): 2026-03-27. End date: 2026-03-28. Decision date: 2025-10-22. Results received: No. Last updated: 2026-03-12.
Decision dates by country: NL: 2025-11-06

Condition(s): Desmoid tumor

Source: https://euclinicaltrials.eu/ctis-public/view/2025-521402-18-00